EU clinical trial 2023-506310-43-00: A Study to Evaluate Safety, Pharmacokinetics, and Preliminary Clinical Activity of RO7276389 Alone and in Combination with Cobimetinib in Participants with BRAF-V600 Mutation-Positive Advanced Solid Tumor or BRAF-V600 Mutation-Positive Melanoma with Central Nervous System Metastases
Protocol code: WP43295
Sponsor: F. Hoffmann-La Roche AG (Pharmaceutical company). Phase: Human Pharmacology (Phase I)- First administration to humans. Countries: Spain (ended), Poland (ended), Belgium (ended), Denmark (ended).
Therapeutic area(s): Diseases [C] - Neoplasms [C04]; Health Care [N] - Environment and Public Health [N06]
Gender: Female, Male. Age: 18-64 years, 65+ years. Enrolment: 70.
Status: Ended. Start date (EU): 2022-02-15. End date (EU): 2026-03-11. End date: 2026-03-12. Decision date: 2024-02-09. Results received: No. Last updated: 2025-12-05.
Decision dates by country: PL: 2024-02-09, ES: 2024-02-12, DK: 2024-02-09, BE: 2024-02-09

Condition(s): BRAF-V600 Mutation-Positive Advanced Solid Tumor or BRAF-V600 Mutation-Positive Melanoma with or without Central Nervous System Metastases

Source: https://euclinicaltrials.eu/ctis-public/view/2023-506310-43-00